EU clinical trial 2023-509073-23-00: OPEN-LABEL PHASE II EFFICACY STUDY OF REPOTRECTINIB IN FRAIL (PS ≥2) AND /OR ELDERLYPATIENTS WITH ROS1-REARRANGED ADVANCED NSCLC
Protocol code: REPOROS GFPC 04-2023
Sponsor: Centre Hospitalier Intercommunal Toulon / La Seine-Sur-Mer, Groupe Français de Pneumo-Oncologie (Hospital/Clinic/Other health care facility, Health care). Phase: Therapeutic exploratory (Phase II). Countries: France (ongoing, recruiting).
Therapeutic area(s): Diseases [C] - Respiratory Tract Diseases [C08]; Diseases [C] - Neoplasms [C04]
Gender: Female, Male. Age: 18-64 years, 65+ years. Enrolment: 30.
Status: Ongoing, recruiting. Start date (EU): 2024-10-01. Decision date: 2024-07-24. Results received: No. Last updated: 2026-06-26.

Condition(s): Stage III/IV non-small-cell lung cancer (NSCLC) harboring an ROS1 gene rearrangement
Product: Repotrectinib (TPX-0005)

Primary endpoint: ORR, defined as the proportion of patients who achieved a complete response (CR) or partial response (PR) according to RECIST v1.1 from the date of first treatment administration until disease progression (or death if patient died before progression) or the introduction of a new treatment assessed by blinded independent central review (BICR).
Endpoint(s): Independent central review of progression free survival (PFS) from Repotrectinib initiation, defined as the time from first dose of Repotrectinib to first documentation of objective disease progression (RECIST v1.1) or to death from any cause. Patients lost to follow-up will be censored as the last date of radiological assessment without progression., DCR, defined as the proportion of patients who achieved a complete response (CR) or partial response (PR) or stable disease (SD) according to RECIST v1.1 assessed by BICR., ic-ORR, defined as the proportion of patients who achieved CR or PR in measurable brain metastases., OS, defined as the time from first dose of Repotrectinib until death from any cause. Patients lost to follow-up will be censored at the last date known to be alive., Proportion (%) of patients with any adverse event (AE) and number of events for all AEs, all serious AEs (SAEs) and all AEs of grade ≥3 according to the National Cancer Institute (NCI) Common terminology criteria for adverse events (CTCAE) v5.0 criteria., DOR, defined as the time from the first documented objective response (CR or PR) until disease progression or death, whichever occurs first., Time to deterioration in lung-related symptoms, defined as the time from inclusion to the time the patient’s score on the EORTC QLQ C30 or QLQ-LC13 shows a ≥10-point increase above baseline in each of the following EORTC-transformed scores for cough, dyspnea (single item), dyspnea (multi-item subscale) and chest pain. Patients lost to follow-up without previous QOL deterioration will be censored at the last EORTC assessment date., Time to deterioration in quality of life, defined as the time from inclusion to the time the patient’s score on the EQ-5D-3L utility score shows a 0.08 point decrease above baseline. Patients lost to follow-up without previous EQ-5D-3L deterioration will be censored at the last EQ-5D-3L assessment., Subgroup analyses: PFS, OS, ORR, DCR, ic-ORR, DOR, duration of treatment and toxicity according to different subgroups : PS ≥ 2 at the time of inclusion ; Age ≥ 70 years, Biospecimens (blood components) to support analyses of cellular components (e.g. protein, DNA, RNA, metabolites) and other circulating molecules, which are collected to identify novel biomarkers (optional biocollection)., Biospecimens (blood components) to support analyses of cellular components (e.g. protein, DNA, RNA, metabolites) and other circulating molecules, which are collected to identify novel biomarkers (optional biocollection).

Source: https://euclinicaltrials.eu/ctis-public/view/2023-509073-23-00